EU clinical trial 2023-509976-40-00: An International, Phase 3, Open-Label, Randomized Study of Zanubrutinib (BGB-3111) Compared With Bendamustine Plus Rituximab in Patients With Previously Untreated Chronic Lymphocytic Leukemia or Small Lymphocytic Lymphoma (CLL/SLL)
Protocol code: BGB-3111-304
Sponsor: BeOne Medicines AG (Pharmaceutical company). Phase: Therapeutic confirmatory (Phase III). Countries: Spain (ongoing, recruitment ended), Poland (ongoing, recruitment ended), Belgium (ongoing, recruitment ended), Austria (ongoing, recruitment ended), Sweden (ongoing, recruitment ended), Czechia (ongoing, recruitment ended), Italy (ongoing, recruitment ended), France (ongoing, recruitment ended).
Therapeutic area(s): Diseases [C] - Neoplasms [C04]
Gender: Female, Male. Age: 18-64 years, 65+ years. Enrolment: 437.
Status: Ongoing, recruitment ended. Start date (EU): 2018-05-28. Decision date: 2024-06-06. Results received: No. Last updated: 2026-06-12.
Decision dates by country: FR: 2024-06-18, IT: 2024-06-11, CZ: 2024-06-10, SE: 2024-06-07, BE: 2024-06-10, PL: 2024-06-10, AT: 2024-06-11, ES: 2024-06-06

Condition(s): Untreated Chronic Lymphocytic Leukemia or Small Lymphocytic Lymphoma
Product: Venclyxto 100 mg film-coated tablets, MabThera 500 mg concentrate for solution for infusion, Zanubrutinib, Venclyxto 50 mg film-coated tablets

Primary endpoint: The primary endpoint is PFS in Cohort 1 (patients without del17p) determined by central review using the iwCLL guidelines with modification for treatment-related lymphocytosis in patients with CLL and the Revised Criteria for Response for Malignant Lymphoma in patients with SLL, and defined as the time from randomization to disease progression or death
Endpoint(s): ORR in Cohort 1 defined as the proportion of patients who achieve a complete response, complete response with incomplete bone marrow recovery, partial response, or partial response with lymphocytosis, determined by independent central review and by investigator assessment, OS in Cohort 1 defined as the time from randomization to the date of death due to any reason, Duration of response in Cohort 1 determined by central review and by investigator assessment using the iwCLL criteria with modification for treatment-related lymphocytosis (in patients with CLL) and the Lugano Classification for NHL (in patients with SLL), and defined as the time from the date that criteria for response are first met to disease progression or death, PFS in Cohort 1 determined by investigator assessment, PROs in Cohort 1 measured by the European Quality of Life 5 Dimensions 5 Levels Health Questionnaire (EQ-5D-5L) and European Organization for Research and Treatment of Cancer Quality of Life Questionnaire Core 30 (EORTC QLQ-C30), PFS in pooled Cohort 1/1a patients from Chinese sites determined by independent central review and by investigator assessment, ORR in pooled Cohort 1/1a patients from Chinese sites determined by independent central review and by investigator assessment, Duration of response in pooled Cohort 1/1a patients from Chinese sites determined by independent central review and by investigator assessment, ORR in Cohort 2 (patients with del17p), Arm C, determined by independent central review and investigator review, PFS in Cohort 2 (Arm C), determined by independent central review and investigator review, Duration of response in Cohort 2 (Arm C), determined by independent central review and investigator review, ORR in Cohort 3, Arm D, determined by investigator review, PFS in Cohort 3 (Arm D), determined by investigator review, Duration of response in Cohort 3 (Arm D), determined by investigator review, Cohort 3 (Arm D) only: undetectable MRD4 rate, Safety parameters, including AEs, SAEs, clinical laboratory tests, physical examination, and vital signs, Pharmacokinetic parameters of zanubrutinib such as apparent clearance of the drug from plasma (CL/F) and AUC from time 0 to 12 hours postdose (AUC0-12) for Arms A, C, and D

Source: https://euclinicaltrials.eu/ctis-public/view/2023-509976-40-00